EU clinical trial 2023-508905-26-00: A study to learn about how much emodepside gets absorbed in the blood and how food affects its absorption when given as a new type of tablet to healthy participants
Protocol code: 22534
Sponsor: Bayer AG (Pharmaceutical company). Phase: Human Pharmacology (Phase I)- Other. Countries: Germany (ended).
Therapeutic area(s): Diseases [C] - Parasitic Diseases [C03]
Gender: Female, Male. Age: 18-64 years. Enrolment: 40.
Status: Ended. Start date (EU): 2024-05-06. End date (EU): 2024-08-27. Decision date: 2024-03-01. Results received: No. Last updated: 2024-03-01.

Condition(s): Onchocerciasis (river blindness): is an infectious disease caused by Onchocerca volvulus, a parasitic nematode worm. The disease is contracted through the bite of an infected blackfly of the genus Simulium, which transmits third-stage infective larvae. An estimated 18 million people suffer from onchocerciasis, with 99% cases in 31 African countries, and 187 million people at risk Onchocercal dermatitis is the most common symptom of the disease, but severe visual impairment and blindness are the most severe complication, and onchocerciasis is the world’s second-leading infectious cause of blindness. Programs for the treatment and control of onchocerciasis through mass drug administration of ivermectin have been in place for over 20 years. However, they require patients to be given treatment (ivermectin) at regular intervals for the life of the adult worm (up to 15 years), making implementation extremely difficult in endemic countries. Emodepside is a registered drug for animal health, marketed by Bayer Animal Health GmbH under the name of Profender® (in combination with praziquantel) or Procox® (in combination with toltrazuril). It is a cyclooctadepsipeptide anthelmintic drug., Soil-transmitted helminth infection: Soil-transmitted helminthiasis is caused by one of the three soil-transmitted helminths (STH), Ascaris lumbricoides, Trichuris trichiura and hookworm (Ancylostoma duodenale and Necator americanus). Currently, STH still infects about 1.5 billion people worldwide, mostly in tropical and subtropical regions. Emodepside is a registered drug for animal health, marketed by Bayer Animal Health GmbH under the name of Profender® (in combination with praziquantel) or Procox® (in combination with toltrazuril). It is a cyclooctadepsipeptide anthelmintic drug.

Source: https://euclinicaltrials.eu/ctis-public/view/2023-508905-26-00